EU clinical trial 2024-518493-14-00: Immunosuppression regimen reduction in kidney transplantation recipients admitted to the intensive care unit in the setting of septic shock and/or acute respiratory failure: an open multicentric randomized phase IV study
Protocol code: 9416
Sponsor: Les Hopitaux Universitaires De Strasbourg (Hospital/Clinic/Other health care facility). Phase: Phase II and Phase III (Integrated). Countries: France (ongoing, recruiting).
Therapeutic area(s): Not possible to specify
Gender: Female, Male. Age: 18-64 years, 65+ years. Enrolment: 212.
Status: Ongoing, recruiting. Start date (EU): 2026-04-10. Decision date: 2025-08-07. Results received: No. Last updated: 2025-11-19.

Condition(s): kidney transplant
Product: CellCept 250 mg capsules, Myfortic 180 mg comprimés gastro-résistants, IMUREL 25 mg, comprimé pelliculé, SOLUMEDROL 500 mg, poudre pour solution injectable, Advagraf 0.5 mg prolonged-release hard capsules, Certican 0,5 mg comprimidos, CORTANCYL 1 mg, comprimé, HYDROCORTISONE UPJOHN 100 mg, préparation injectable, Neoral 100 mg Soft Capsules, Rapamune 0.5 mg coated tablets

Primary endpoint: The primary endpoint is the rate of patients showing a reduction in the SOFA (Sequential Organ Failure Assessment) score of at least 4 points at day 5
Endpoint(s): Vital status at discharge from the ICU and at month 6, Daily evolution of the SOFA score (from day 1 to day 7), Serum creatinine level and glomerular filtration rate (GFR, in ml/min) at discharge from the ICU, assessed by the UV/P method (urine creatinine * diuresis / plasma creatinine). Given the usual collection of 24-hour urine in intensive care, this cost-effective approach is easily achievable and is the most relevant in intensive care, Dialysis status (during ICU stay and at month 6): use of dialysis, modality of dialysis, weaning from RRT at discharge between ICU discharge and month 6, Histological evidence (graft biopsy) and characterization of rejection according to the Banff classification, for any sample taken between discharge from the ICU and month 6 (biopsy for cause only)., Evaluation of anti-HLA immunization will be performed on a blood sample at month 6, with screening for Donor-Specific Antibodies, Collection of significant infection episodes from ICU discharge to month 6. An infection will be considered significant if it requires hospitalization. Additionally, during the 6-month consultation, blood replication for CMV, EBV, and BK virus and urinary replication of BK virus (assessed with Polymerase Chain Reaction tests) will be collected as part of routine care

Source: https://euclinicaltrials.eu/ctis-public/view/2024-518493-14-00